EU clinical trial 2023-505733-28-00: Chronic anticoagulation in end-stage renal disease patients: pharmacocinetics and pharmacodynamic of a reduced dose regimen of rivaroxaban (CARD-AXA)
Sponsor: Centre Hospitalier Regional Universitaire De Tours (Hospital/Clinic/Other health care facility). Phase: Therapeutic exploratory (Phase II). Countries: France (ongoing, recruiting).
Therapeutic area(s): Diseases [C] - Cardiovascular Diseases [C14]; Diseases [C] - Male Urogenital Diseases [C12]; Diseases [C] - Female Urogenital Diseases and Pregnancy Complications [C13]
Gender: Female, Male. Age: 18-64 years. Enrolment: 12.
Status: Ongoing, recruiting. Start date (EU): 2025-01-08. Decision date: 2024-04-19. Results received: No. Last updated: 2025-12-19.

Condition(s): Chronic hemodialysis
Product: Xarelto 2.5 mg film-coated tablets

Primary endpoint: Area under the AUC curve (drug dosage and anti-Xa activity) for each of the 3 doses of rivaroxaban (5, 10 and 15 mg/d)
Endpoint(s): Occurrence of bleeding events graded according to the BARC classification during the study period

Source: https://euclinicaltrials.eu/ctis-public/view/2023-505733-28-00